EU clinical trial 2023-508477-87-00: PHASE IB/II CLINICAL TRIAL EVALUATING THE SAFETY AND EFFICACY OF CHEMOIMMUNOTHERAPY PLUS SHORT COURSE OF MEK INHIBITOR IN FIRST LINE OF TREATMENT OF METASTATIC NON SQUAMOUS NON SMALL CELL LUNG ADENOCARCINOMA WITH PDL1 <50%
Sponsor: Centr Georges Francois Leclerc (Hospital/Clinic/Other health care facility). Phase: Phase I and Phase II (Integrated)- Other. Countries: France (ongoing, recruiting).
Therapeutic area(s): Diseases [C] - Neoplasms [C04]
Gender: Female, Male. Age: 18-64 years, 65+ years. Enrolment: 102.
Status: Ongoing, recruiting. Start date (EU): 2024-07-24. Decision date: 2024-03-04. Results received: No. Last updated: 2026-07-01.

Condition(s): Patients with localy advanced or metastatic non squamous non small cell lung cancer with PDL1˂50%.

Source: https://euclinicaltrials.eu/ctis-public/view/2023-508477-87-00